EU clinical trial 2022-500919-40-01: A Phase IIa, Open Label, Proof of Concept Study to Evaluate the Safety of Aqueous Afamelanotide Solution in Patients with acute Arterial Ischaemic Stroke (AIS) who are ineligible for Intravenous Thrombolysis (IVT) or Endovascular Thrombectomy (EVT)
Protocol code: CUV803
Sponsor: Clinuvel Europe Limited (Pharmaceutical company). Phase: Therapeutic exploratory (Phase II). Countries: Spain (ended).
Therapeutic area(s): Diseases [C] - Nervous System Diseases [C10]
Gender: Female, Male. Age: 18-64 years, 65+ years. Enrolment: 12.
Status: Ended. Start date (EU): 2023-03-10. End date (EU): 2024-11-19. Decision date: 2024-10-15. Results received: Yes. Last updated: 2024-10-15.

Condition(s): Arterial Ischaemic Stroke (AIS)
Product: PRENUMBRA

Primary endpoint: Safety of afamelanotide by monitoring and recording treatment-emergent AEs (TEAEs)
Endpoint(s): NIHSS scores compared to baseline, Reperfusion volume of the ischaemic core and the penumbral ischaemic zone (salvageable tissue), mRS scores compared to baseline and pre-stroke; Activities of Daily Living (ADL) compared to baseline and pre-stroke, MMSE scores compared to baseline

Source: https://euclinicaltrials.eu/ctis-public/view/2022-500919-40-01